EU clinical trial 2023-506150-21-00: A Phase II, Double-Blind, Randomised, Placebo-Controlled Trial to Evaluate the Efficacy and Tolerability of ZED1227 in Celiac Disease Subjects Experiencing Symptoms Despite Gluten-Free Diet
Protocol code: CEC-013/CEL
Sponsor: Dr. Falk Pharma GmbH (Pharmaceutical company). Phase: Therapeutic exploratory (Phase II). Countries: Norway (ongoing, recruiting), Sweden (ongoing, recruiting), Austria (ongoing, recruitment ended), Poland (ongoing, recruiting), Germany (ongoing, recruiting), Finland (ongoing, recruiting), Spain (ongoing, recruiting), Croatia (ongoing, recruitment ended), Romania (ongoing, recruiting), Ireland (authorised, recruitment pending), Italy (authorised, recruitment pending).
Therapeutic area(s): Diseases [C] - Digestive System Diseases [C06]
Gender: Female, Male. Age: 18-64 years, 65+ years. Enrolment: 461.
Start date (EU): 2024-05-29. Decision date: 2024-04-16. Results received: No. Last updated: 2026-07-28.
Decision dates by country: ES: 2024-04-16, AT: 2024-04-22, NO: 2024-04-16, PL: 2024-04-22, SE: 2024-04-22, FI: 2024-04-17, HR: 2024-04-19, RO: 2024-04-19, DE: 2024-04-17, IE: 2026-06-26, IT: 2026-07-28

Condition(s): Celiac Disease
Product: Placebo matching with ZED1227 capsules of Dr. Falk Pharma GmbH, CEC02, CEC03

Primary endpoint: Change in CDSD GI Specific Symptom Score (diarrhoea, abdominal pain, bloating, nausea) from Baseline Visit B (V2, Wk 3) to V5 (Wk 15).
Endpoint(s): Change in VH: CrD from Baseline Visit A (V1, Wk 0) to V5 (Wk 15),, Change in CDSD Non-Stool GI Symptom Score (abdominal pain, bloating, nausea) from Baseline Visit B (V2, Wk 3) to V5 (Wk 15),, Change in duodenal mucosal inflammation measured as the density of CD3-positive intraepithelial lymphocytes (IELs) from Baseline Visit A (V1, Wk 0) to V5 (Wk 15).

Source: https://euclinicaltrials.eu/ctis-public/view/2023-506150-21-00